EU clinical trial 2023-508890-10-00: A Phase 3, randomized, double-blind clinical study of pembrolizumab (MK-3475) plus chemotherapy versus placebo plus chemotherapy as first-line treatment in participants with HER2 negative, previously untreated, unresectable or metastatic gastric or gastroesophageal junction adenocarcinoma (KEYNOTE-859)
Protocol code: MK3475-859
Sponsor: Merck Sharp & Dohme LLC (Pharmaceutical company). Phase: Therapeutic confirmatory (Phase III). Countries: Denmark (ended), France (ended), Ireland (ended), Czechia (ended), Poland (ended), Spain (ended), Germany (ended), Italy (ended).
Therapeutic area(s): Diseases [C] - Neoplasms [C04]
Gender: Female, Male. Age: 18-64 years, 65+ years. Enrolment: 268.
Status: Ended. Start date (EU): 2018-12-05. End date (EU): 2025-03-03. End date: 2025-03-04. Decision date: 2024-04-30. Results received: Yes. Last updated: 2025-03-19.
Decision dates by country: IT: 2024-05-22, DK: 2024-04-30, ES: 2024-05-22, CZ: 2024-05-02, PL: 2024-05-06, DE: 2024-05-06, FR: 2024-05-06, IE: 2024-04-30

Condition(s): Gastric and gastric esophageal junction (GEJ) adenocarcinoma
Product: Placebo for pembrolizumab, KEYTRUDA 25 mg/mL concentrate for solution for infusion, CAPECITABINE, FLUOROURACIL, OXALIPLATIN, CISPLATIN

Primary endpoint: OS in All Participants, OS In Participants With PD-L1 CPS ≥1, OS In Participants With PD-L1 CPS ≥10
Endpoint(s): PFS Per RECIST 1.1 Assessed by BICR in All Participants, PFS Per RECIST 1.1 Assessed by BICR In Participants With PD-L1 CPS ≥1, PFS Per RECIST 1.1 Assessed by BICR In Participants With PD-L1 CPS ≥10, ORR Per RECIST 1.1 Assessed by BICR in All Participants, ORR Per RECIST 1.1 Assessed by BICR in Participants With PD-L1 CPS ≥1, ORR Per RECIST 1.1 Assessed by BICR in Participants With PD-L1 CPS ≥10, DOR Per RECIST 1.1 Assessed by BICR in All Participants, DOR Per RECIST 1.1 Assessed by BICR In Participants With PD-L1 CPS ≥1, DOR Per RECIST 1.1 Assessed by BICR In Participants With PD-L1 CPS ≥10, Number of Participants Who Experienced an Adverse Event (AE), Number of Participants Who Discontinued Study Treatment Due To an AE

Source: https://euclinicaltrials.eu/ctis-public/view/2023-508890-10-00